EU clinical trial 2023-506167-34-02: Improving inpatient GHB detoxification with baclofen: A proof of concept and dose-finding study.
Protocol code: PaNaMa ID: 114633
Sponsor: Stichting Radboud University Medical Center (Hospital/Clinic/Other health care facility). Phase: Therapeutic exploratory (Phase II). Countries: Netherlands (ongoing, recruiting).
Therapeutic area(s): Psychiatry and Psychology [F] - Behavior and Behavior Mechanisms [F01]
Gender: Female, Male. Age: 18-64 years. Enrolment: 28.
Status: Ongoing, recruiting. Start date (EU): 2025-06-16. Decision date: 2023-12-14. Results received: No. Last updated: 2023-12-14.

Condition(s): GHB use disorder
Product: Baclofen Mylan 10 mg, tabletten, Baclofen Mylan 25 mg, tabletten, Xyrem 500 mg/mL oral solution

Primary endpoint: The main study parameter is pharmaceutical GHB dosage at the end of the titration phase during inpatient detoxification in patients with GUD

Source: https://euclinicaltrials.eu/ctis-public/view/2023-506167-34-02